EU clinical trial 2024-510761-42-00: A first-in-human study of the safety of an immunosuppressive antibody (IMP761) in healthy volunteers.
Protocol code: IMP761-P001
Sponsor: Immutep (Pharmaceutical company). Phase: Human Pharmacology (Phase I)- First administration to humans. Countries: Netherlands (ongoing, recruiting).
Therapeutic area(s): Diseases [C] - Immune System Diseases [C20]
Gender: Female, Male. Age: 18-64 years. Enrolment: 79.
Status: Ongoing, recruiting. Start date (EU): 2024-07-17. Decision date: 2024-07-16. Results received: No. Last updated: 2026-04-29.
Decision dates by country: NL: 2024-08-09

Condition(s): autoimmunity

Source: https://euclinicaltrials.eu/ctis-public/view/2024-510761-42-00